EU clinical trial 2022-502498-40-00: A Phase 3b, open-label, single-arm, rollover study to evaluate long-term safety in subjects who have participated in other luspatercept (ACE-536, also known as BMS 986346) clinical trials.
Protocol code: ACE-536-LTFU-001
Sponsor: Celgene Corp. (Pharmaceutical company). Phase: Therapeutic confirmatory (Phase III). Countries: Greece (ongoing, recruiting), Italy (ongoing, recruiting), Germany (ended), Spain (ended), France (ended), Bulgaria (ended), Netherlands (ended), Sweden (ended).
Therapeutic area(s): Diseases [C] - Hemic and Lymphatic Diseases [C15]
Gender: Female, Male. Age: 18-64 years, 65+ years. Enrolment: 139.
Start date (EU): 2019-07-26. Decision date: 2024-02-20. Results received: No. Last updated: 2025-12-22.
Decision dates by country: NL: 2024-02-21, ES: 2024-02-22, DE: 2024-02-22, FR: 2024-02-26, BG: 2024-02-21, SE: 2024-02-20, IT: 2024-02-23, GR: 2024-03-22

Condition(s): myelodysplastic syndrome (MDS); beta (β)-thalassemia (THAL); myelofibrosis (MF)
Product: Reblozyl 75 mg powder for solution for injection, Reblozyl 25 mg powder for solution for injection

Primary endpoint: Adverse events (AEs), Progression to high/very high-risk myelodysplastic syndrome (MDS), Progression to Acute myeloid leukemia (AML) (MDS and myelofibrosis [MF] only), Development of other malignancies/premalignancies
Endpoint(s): Overall survival, Treatment-emergent EMH masses

Source: https://euclinicaltrials.eu/ctis-public/view/2022-502498-40-00